EU clinical trial 2023-503822-38-00: Randomized, open-label, single dose, two-period, cross-over bioequivalence study comparing test formulation Rosuvastatin/Amlodipine/Ramipril capsule, hard 10mg/5mg/5mg versus reference products Crestor 10 mg film coated tablets, Norvasc 5 mg tablets, Tritace 5 mg tablets in healthy male and female subjects under fasting conditions. Sponsor’s Study Number: ROS-AML-RAM-BIO-02-23
Sponsor: Adamed Pharma S.A. (Pharmaceutical company). Phase: Human Pharmacology (Phase I)- Bioequivalence Study. Countries: Czechia (ended).
Therapeutic area(s): Diseases [C] - Cardiovascular Diseases [C14]
Gender: Female, Male. Age: 18-64 years. Enrolment: 60.
Status: Ended. Start date (EU): 2023-06-19. End date (EU): 2023-08-22. Decision date: 2023-05-16. Results received: Yes. Last updated: 2023-07-03.

Condition(s): Not applicable (submitted trial is a bioequivalence study in healthy subject).
Product: TRITACE 5 mg comprimate, Norvasc 5 mg tabletes, Crestor 10 mg apvalkotās tabletes, Rosuvastatin/Amlodipine/Ramipril capsule, hard 10/5/5 mg

Primary endpoint: AUC(0-72h) or AUC(0-t), and Cmax. 90% confidence intervals for the Test to Reference ratio of LSM for rosuvastatin, amlodipine and ramipril and a based on ln-transformed data of AUC(0-t) or AUC(0-72h) and Cmax will be calculated and compared with acceptance limits AUC(0-t) or AUC(0-72h) 80.00 ‒ 125.00%, Cmax 80.00 ‒ 125.00%
Endpoint(s): tmax, AUC(0-∞), AUCres, t1/2 and λz (if applicable)

Source: https://euclinicaltrials.eu/ctis-public/view/2023-503822-38-00